EU clinical trial 2024-513617-13-00: Prevention of HEMOrhagic risk in upper MYOmeCTomy by use of Misoprostol.
Protocol code: RBHP 2024 GREMEAU
Sponsor: University Hospital Of Clermont-Ferrand (Hospital/Clinic/Other health care facility). Phase: Therapeutic exploratory (Phase II). Countries: France (ongoing, recruiting).
Therapeutic area(s): Diseases [C] - Female Urogenital Diseases and Pregnancy Complications [C13]; Analytical, Diagnostic and Therapeutic Techniques and Equipment [E] - Therapeutics [E02]
Gender: Female. Age: 18-64 years. Enrolment: 80.
Status: Ongoing, recruiting. Start date (EU): 2025-04-14. Decision date: 2024-12-19. Results received: No. Last updated: 2025-06-05.

Condition(s): fibroma
Product: PLACEBO, MisoOne 400 mikrogramų tabletės

Primary endpoint: Intraoperative blood loss measured in mL (volume in the suction and blood volumes in the compresses after weighing) according to the randomization group.
Endpoint(s): Depending on the randomization group, compare the difference in hemoglobin pre- and post-operatively then at 1 month and hemoglobin level, Depending on the randomization group, compare: Demographic characteristics of patients and fibroids: BMI, Age, Gesture, Parity, Ethnicity, Tobacco, Taking pre-operative hormonal treatment, Type of treatment., Depending on the randomization group, compare: Characteristics of myomas: Types of myomas (FIGO), Size of myomas, Number of myomas., Depending on the randomization group, compare the duration between taking the tablet and anesthetic induction then the incision, Depending on the randomization group, compare the duration between incision or pneumoperitoneum and closure, Depending on the randomization group, compare the accounting for the number of RGCs transfused., Depending on the randomization group, compare the collection of early postoperative complications., Depending on the randomization group, compare : EVA at H+2, H+6 D1 M1., Depending on the randomization group, compare : Length of hospitalization in days., Depending on the type of surgery compare the difference in hemoglobin pre- and post-operatively then at 1 month and hemoglobin level, Depending on the type of surgery compare the demographic characteristics of patients and fibroids: BMI, Age, Gesture, Parity, Ethnicity, Tobacco, Taking pre-operative hormonal treatment, Type of treatment., Depending on the type of surgery compare the characteristics of myomas: Types of myomas (FIGO), Size of myomas, Number of myomas., Depending on the type of surgery compare the duration between taking the tablet and anesthetic induction then the incision, Depending on the type of surgery compare the duration between incision or pneumoperitoneum and closure., Depending on the type of surgery compare the accounting for the number of RGCs transfused., Depending on the type of surgery compare the collection of early postoperative complications., Depending on the type of surgery compare EVA at H+2, H+6 D1 M1, Depending on the type of surgery compare the length of hospitalization in days., Intraoperative blood loss measured in mL (volume in aspiration and blood volumes in compresses after weighing) according to the randomization group and surgical technique.

Source: https://euclinicaltrials.eu/ctis-public/view/2024-513617-13-00